EU clinical trial 2023-505579-53-00: A Phase 3, Single-Arm, Open-Label, Multicenter Study to Evaluate the Safety and Efficacy of Tafasitamab Plus Lenalidomide in Participants With Relapsed or Refractory Diffuse Large B-Cell Lymphoma
Protocol code: INCMOR 0208-305
Sponsor: Incyte Corp. (Pharmaceutical company). Phase: Therapeutic confirmatory (Phase III). Countries: Czechia (ongoing, recruitment ended), Ireland (ongoing, recruitment ended), Hungary (ongoing, recruitment ended), Finland (ongoing, recruitment ended), Denmark (ongoing, recruitment ended), Norway (ended), Romania (ongoing, recruitment ended), Croatia (ended), Poland (ongoing, recruitment ended), Bulgaria (ongoing, recruitment ended).
Therapeutic area(s): Diseases [C] - Neoplasms [C04]
Gender: Female, Male. Age: 18-64 years, 65+ years. Enrolment: 74.
Start date (EU): 2022-10-25. Decision date: 2023-11-28. Results received: No. Last updated: 2026-07-22.
Decision dates by country: HR: 2023-12-14, HU: 2023-11-28, NO: 2023-11-28, BG: 2024-01-23, CZ: 2023-11-29, PL: 2024-01-15, IE: 2023-11-28, RO: 2023-12-08, DK: 2023-11-28, FI: 2023-12-01

Condition(s): Diffuse large B-cell lymphoma (DLBCL)
Product: Zelvina 5 mg hard capsules, Zelvina 20 mg hard capsules, Zelvina 10 mg hard capsules, Zelvina 15 mg hard capsules, Zelvina 25 mg hard capsules, MINJUVI 200 mg powder for concentrate for solution for infusion

Primary endpoint: ORR (overall response rate), defined as the percentage of participants having best response of CR or PR as per IRC assessment.
Endpoint(s): • DOR (Duration of Response), defined as time from 1st documented CR (complete response) or PR (partial response) until the date of 1st documented disease progression or death due to any cause, whichever occurs first, among participants who achieve CR or PR per IRC (independent review committee) assessment. Refer protocol for complete list.

Source: https://euclinicaltrials.eu/ctis-public/view/2023-505579-53-00